EU clinical trial 2023-503577-38-00: A randomized, placebo-controlled clinical trial to evaluate the safety, tolerability, pharmacokinetics, immunogenicity, pharmacodynamics and exploratory clinical activity of NM26-2198 in healthy subjects and in patients with moderate-to-severe atopic dermatitis (AD)
Protocol code: NB-NM026-2198-101
Sponsor: Yellow Jersey Therapeutics AG (Pharmaceutical company). Phase: Human Pharmacology (Phase I)- First administration to humans. Countries: Germany (ended), Poland (ended).
Therapeutic area(s): Diseases [C] - Skin and Connective Tissue Diseases [C17]
Gender: Female, Male. Age: 18-64 years, 65+ years. Enrolment: 14.
Status: Ended. Start date (EU): 2023-12-07. End date (EU): 2024-10-01. End date: 2024-10-02. Decision date: 2023-09-15. Results received: No. Last updated: 2024-12-05.
Decision dates by country: PL: 2023-09-18, DE: 2023-09-15

Condition(s): Atopic Dermatitis

Source: https://euclinicaltrials.eu/ctis-public/view/2023-503577-38-00